EU clinical trial 2022-501939-16-00: HERMES: Effects of ziltivekimab versus placebo on morbidity and mortality in patients with heart failure with mildly reduced or preserved ejection fraction and systemic inflammation
Protocol code: EX6018-4915
Sponsor: Novo Nordisk A/S (Pharmaceutical company). Phase: Therapeutic confirmatory (Phase III). Countries: Denmark (ongoing, recruitment ended), France (ongoing, recruitment ended), Ireland (ongoing, recruitment ended), Italy (ongoing, recruitment ended), Croatia (ongoing, recruitment ended), Slovenia (ongoing, recruitment ended), Netherlands (ongoing, recruitment ended), Poland (ongoing, recruitment ended), Czechia (ongoing, recruitment ended), Portugal (ongoing, recruitment ended), Finland (ongoing, recruitment ended), Spain (ongoing, recruitment ended), Greece (ongoing, recruitment ended), Belgium (ongoing, recruitment ended), Bulgaria (ongoing, recruitment ended), Hungary (ongoing, recruitment ended), Austria (ongoing, recruitment ended), Estonia (ongoing, recruitment ended), Latvia (ongoing, recruitment ended), Lithuania (ongoing, recruitment ended), Norway (ongoing, recruitment ended), Slovakia (ongoing, recruitment ended), Germany (ongoing, recruitment ended), Romania (ongoing, recruitment ended).
Therapeutic area(s): Diseases [C] - Cardiovascular Diseases [C14]
Gender: Female, Male. Age: 18-64 years, 65+ years. Enrolment: 2212.
Status: Ongoing, recruitment ended. Start date (EU): 2023-05-09. Decision date: 2023-05-01. Results received: No. Last updated: 2026-07-28.
Decision dates by country: DE: 2023-05-17, EE: 2023-05-08, SK: 2023-05-02, NO: 2023-07-25, SI: 2023-05-08, HU: 2023-05-04, GR: 2023-05-02, IE: 2023-05-05, BE: 2023-05-02, HR: 2023-05-08, RO: 2023-05-08, NL: 2023-05-08, LT: 2023-05-05, PL: 2023-05-08, CZ: 2023-05-02, FI: 2023-05-08, LV: 2023-05-03, DK: 2023-05-01, BG: 2023-05-09, FR: 2023-05-04, IT: 2023-05-05, PT: 2023-05-03, ES: 2023-05-03, AT: 2023-05-08

Condition(s): Heart failure (HF) with mildly reduced ejection fraction (HFmrEF) or HF with preserved ejection fraction (HFpEF) and systemic inflammation.
Product: ziltivekimab, Placebo (ziltivekimab), ziltivekimab, Placebo (ziltivekimab)

Primary endpoint: Time to first occurrence of a composite HF endpoint consisting of CV death, HF hospitalisation or urgent HF visit from randomisation to end of study., Number of CV deaths, HF hospitalisations or urgent HF visits (first and recurrent) from randomisation to end of study.
Endpoint(s): Time to first occurrence of 4-point expanded composite HF endpoint, a composite endpoint consisting of CV death, HF hospitalisation or urgent HF visit, Non-fatal MI and Non-fatal stroke. Measued from randomisation to end of study, Time to first occurrence of 4-point expanded composite HF endpoint, a composite endpoint consisting of all-cause death, HF hospitalisation or urgent HF visit, Non-fatal MI and Non-fatal stroke. Measued from randomisation to end of study, Time to occurrence of CV death from randomisation to end of study, Time to occurrence of all-cause death from randomisation to end of study, Hierarchical composite of Time to all-cause death, number of HF hospitalisation or urgent HF visits, time to first HF hospitalisation or urgent HF visit (measured from randomisation to end of study) and difference of at least 5 in KCCQ clinical summary score change from baseline to 12 months (assessed by the win ratio), Time to first occurrence of HF hospitalisation or urgent HF visit from randomisation to end of study, Number of events of atrial fibrillation from randomisation to end of study, Change in KCCQ clinical summary score from randomisation to 12 months, Improvement of 5 points or more in KCCQ clinical summary score (yes/no) ) from randomisation to 12 months, Improvement of 10 points or more in KCCQ clinical summary score (yes/no) from randomisation to 12 months, Improvement in NYHA Class (yes/no) from randomisation to 12 months, Time to first occurrence of a composite CKD endpoint consisting of CV death, onset of persistent ≥ 40% reduction in eGFR (CKD-EPI) compared with baseline and kidney failure (defined as death from kidney failure, onset of persistent eGFR< 15 mL/min/1.73 m^2 (CKD-EPI), initiation of chronic kidney replacement therapy (maintenance dialysis or kidney transplantation). Measured from randomisation to end of study, Change in eGFR (CKD-EPI) from randomisation to 12 months, Annual rate of change in eGFR (CKD-EPI) (total eGFR slope) from randomisation to end of study, Number of hospitalisations with infection as primary cause or death due to infection. Measured from randomisation to end of study, Change in hs-CRP from randomisation to 12 months, Change in NT-proBNP from randomisation to 12 months, Change in CCI from randomisation to 12 months, Participants achieving threshold of meaningful within-patient change (MWPC) in KCCQ-CSS (yes/no) from randomisation to 12 months

Source: https://euclinicaltrials.eu/ctis-public/view/2022-501939-16-00